EU clinical trial 2023-507816-11-00: Long-term need of Ranibizumab injections with or without early targeted peripheral laser photocoagulation for treatment of macular edema due to central retinal vein occlusion (CoRaLa II trial)
Protocol code: CoRaLa II
Sponsor: Justus-Liebig-Universitaet Giessen (Educational Institution). Phase: Therapeutic confirmatory (Phase III). Countries: Germany (ongoing, recruitment ended), Austria (ongoing, recruitment ended).
Therapeutic area(s): Diseases [C] - Eye Diseases [C11]
Gender: Female, Male. Age: 18-64 years, 65+ years. Enrolment: 110.
Status: Ongoing, recruitment ended. Start date (EU): 2020-08-17. Decision date: 2023-10-30. Results received: No. Last updated: 2025-10-17.
Decision dates by country: DE: 2023-11-06, AT: 2023-10-30

Condition(s): Macular edema due to central retinal vein occlusion
Product: RANIBIZUMAB

Primary endpoint: Primary efficacy endpoint is the time to treatment success, defined as time from randomisation until the date of last criteria-based intravitreal injection in case that thereafter a treatment-free period for (at least) 6 months was observed. Objective criteria for further treatment indication (according to details in section 6.3) have to be fulfilled for decisions regarding further re-treatment. Drop-outs/deaths without earlier success will be censored at the end of their observation time and al
Endpoint(s): the best corrected visual acuity (BCVA) in BCVA letter scores (EDTRS charts) per visit, central subfield thickness (CST) measured by OCT per visit, the number of Ranibizumab injections required (after three initial monthly injections) according to re-treatment criteria (see 6.3) until “success” is reached as well as up to month 29 after randomisation (the entire period of observation, in case of late recurrence of ME)

Source: https://euclinicaltrials.eu/ctis-public/view/2023-507816-11-00